EU clinical trial 2025-522932-15-00: A study to investigate the safety, pharmacokinetics, pharmacodynamics, and immunogenicity of a CD19/CD20 T-cell engager in participants with B-cell driven ARD.
Protocol code: 300134
Sponsor: Glaxosmithkline Research & Development Limited (Pharmaceutical company). Phase: Human Pharmacology (Phase I)- Other. Countries: Germany (authorised, recruitment pending), France (authorised, recruitment pending), Italy (authorised, recruitment pending), Spain (authorised, recruitment pending), Poland (authorised, recruitment pending).
Therapeutic area(s): Diseases [C] - Immune System Diseases [C20]
Gender: Female, Male. Age: 18-64 years, 65+ years. Enrolment: 18.
Status: Authorised, recruitment pending. Decision date: 2026-03-23. Results received: No. Last updated: 2026-07-29.
Decision dates by country: PL: 2026-03-27, DE: 2026-03-26, IT: 2026-03-23, ES: 2026-03-27, FR: 2026-03-23

Condition(s): Systemic Lupus Erythematosus

Source: https://euclinicaltrials.eu/ctis-public/view/2025-522932-15-00